EU clinical trial 2024-511377-30-00: A Phase 2/3 Multicenter, Randomized, Double-blind, Placebo-controlled and Open-label Extension Trial to Evaluate the Efficacy and Safety of Aficamten in a Pediatric Population with Symptomatic Obstructive Hypertrophic Cardiomyopathy
Protocol code: CY 6023
Sponsor: Cytokinetics Inc. (Pharmaceutical company). Phase: Phase II and Phase III (Integrated). Countries: Spain (ongoing, recruiting), Italy (ongoing, recruiting), Ireland (authorised, recruitment pending).
Therapeutic area(s): Diseases [C] - Cardiovascular Diseases [C14]
Gender: Female, Male. Age: 0-17 years. Enrolment: 6.
Start date (EU): 2025-01-23. Decision date: 2024-12-02. Results received: No. Last updated: 2026-06-12.
Decision dates by country: ES: 2024-12-02, IE: 2026-06-12, IT: 2024-12-02

Condition(s): SYMPTOMATIC OBSTRUCTIVE HYPERTROPHIC CARDIOMYOPATHY
Product: Aficamten, Tablet placebo for aficamten 5mg tablet

Primary endpoint: P1: Change in Valsalva LVOT-G from baseline to Week 12, P2: Participant incidence of AEs and SAEs through End of Study
Endpoint(s): P1: Change in resting LVOT-G from baseline to Week 12, P1: All participants: Observed Ctrough and C2h postdose of aficamten over the 12-week treatment period Intensive PK substudy: Observed Cmax, tmax, AUCtau, and Ctrough for aficamten., P1: Change in NT-proBNP from baseline to Week 12 Change in hs-cTnI from baseline to Week 12, P1: Change in NYHA Functional Class from baseline to Week 12, P1: Proportion of participants with ≥ 1 class improvement in NYHA Functional Class from baseline to Week 12, P2: Change in the following measurements at 12-week intervals (Period 2) and 24-week intervals (Period 3) from Week 14 through Week 66 (Period 2) and end of treatment (Period 3): − Peak LVOT-G at rest and with Valsalva provocation., P2: Change in the following measurements at 12-week intervals (Period 2) and 24-week intervals (Period 3) from Week 14 through Week 66 (Period 2) and end of treatment (Period 3): Proportion of participants with resting LVOT-G < 30 mmHg, P2: Change in the following measurements at 12-week intervals (Period 2) and 24-week intervals (Period 3) from Week 14 through Week 66 (Period 2) and end of treatment (Period 3): − Proportion of participants with Valsalva LVOT-G < 50 mmHg, P2: (Period 2) and 24-week intervals (Period 3) from Week 14 through Week 66 (Period 2) and end of treatment (Period 3): − Proportion of participants with Valsalva LVOT-G < 30 mmHg, P2: (Period 2) and 24-week intervals (Period 3) from Week 14 through Week 66 (Period 2) and end of treatment (Period 3):: − Proportion of participants with LVEF ≥ 50%, resting LVOT-G < 30 mmHg, and Valsalva LVOT-G < 50 mmHg, P2: Time to the following event through last follow-up: − First resting LVOT-G < 30 mmHg − First Valsalva LVOT-G < 50 mmHg − First Valsalva LVOT-G < 30 mmHg − First LVEF ≥ 50%, resting LVOT-G < 30 mmHg, and Valsalva LVOT-G < 50 mmHg, P2: Change in NYHA Functional Class from Week 14 to Week 66 (Period 2) and end of treatment (Period 3), P2: Proportion of participants with ≥ 1 class improvement in NYHA Functional Class from Week 14 to Week 66 (Period 2) and end of treatment (Period 3)

Source: https://euclinicaltrials.eu/ctis-public/view/2024-511377-30-00